EU clinical trial 2023-507249-27-00: Integrated exploratory phase 1/2a study, double-blind, randomized, controlled to evaluate the Safety and Efficacy of FTP-002 / FTP-501 combination in the treatment of glabellar lines
Protocol code: FTP-CLIN-01
Sponsor: Fastox Pharma S.A. (Pharmaceutical company). Phase: Phase I and Phase II (Integrated)- First administration to humans. Countries: Germany (ended).
Therapeutic area(s): Not possible to specify
Gender: Female. Age: 18-64 years. Enrolment: 116.
Status: Ended. Start date (EU): 2024-11-26. End date (EU): 2026-06-16. Decision date: 2024-05-28. Results received: No. Last updated: 2025-11-26.

Condition(s): glabellar lines.
Product: Dantrolene sodium semiheptahydrate, SODIUM CHLORIDE, VISTABEL 4 Allergan-Einheiten/0,1 ml Pulver zur Herstellung einer Injektionslösung, FTP-002/FTP-501 combination

Primary endpoint: Part1: • Percentage of responders with at least +1 grade of improvement from baseline on ILA at each post-treatment visit (at maximum frown and at rest)., Part 1: • Percentage of responders with at least +1 grade of improvement from baseline on SSA at each post-treatment visit (at maximum frown and at rest)., Part 1: • Percentage of responders with at least +2 grade of improvement from baseline on ILA at each post-treatment visit (maximum frown and at rest)., Part 1: • Percentage of responders with at least +2 grade of improvement from baseline on SSA at each post-treatment visit (maximum frown and at rest)., Part 1: • Duration of treatment response based on the ILA at maximum frown (from D1 injection to return to baseline level) (for responders with at least +1 grade improvement from baseline)., Part 1: • Duration of treatment response based on the ILA at maximum frown (from D1 injection to return to baseline level) (for all participants where non-responders are treated as duration 0)., Part 1: • Duration of treatment response based on the ILA at rest (from D1 injection to return to baseline level) (for responders with at least +1 grade improvement from baseline)., Part 1: • Duration of treatment response based on the ILA at rest (from D1 injection to return to baseline level) (for all participants where non-responders are treated as duration 0)., Part 2: o Duration of treatment response based on the ILA at maximum frown (from D1 injection to return to baseline level) (for responders with at least +1 grade improvement from baseline).
Endpoint(s): o Percentage of responders with at least +1 grade of improvement from baseline on ILA at maximum frown at 6 months, o Percentage of responders with at least +1 grade of improvement from baseline on ILA at each post-treatment visit (at maximum frown and at rest)., o Percentage of responders with at least +1 grade of improvement from baseline on SSA at each post-treatment visit (at maximum frown and at rest)., o Percentage of responders with at least +2 grade of improvement from baseline on ILA at each post-treatment visit (maximum frown and at rest)., o Percentage of responders with at least +2 grade of improvement from baseline on SSA at each post-treatment visit (maximum frown and at rest)., o Percentage of responders with a severity grade of “none” or “mild” (maximum frown and at rest) on ILA using each post-treatment visit., o Response to treatment as achieved by a score of “very much improved” or “much improved” or “Improved” on the participant’s GAIS at each post-treatment visit., o Time to onset of treatment response with at least +1 improvement from baseline of ILA at maximum frown and at rest (Day 1 through Day 8)., o Duration of treatment response based on the ILA at maximum frown (from D1 injection to return to baseline level)., o The duration of treatment response based on the ILA at rest (from D1 injection to return to baseline level)., o The duration of treatment response based on the ILA at rest (from D1 injection to return to baseline level)., o The duration of treatment response based on the SSA at maximum frown (from D1 injection to return to baseline level)., o The duration of treatment response based on the SSA at maximum frown (from D1 injection to return to baseline level)., o The duration of treatment response based on the SSA at rest (from D1 injection to return to baseline level)., o The duration of treatment response based on the SSA at rest (from D1 injection to return to baseline level)., o Area under the curve (AUC) of mean score of GL severity at maximum frown and at rest by ILA., o AUC of mean score of GL severity at maximum frown and at rest by SSA.

Source: https://euclinicaltrials.eu/ctis-public/view/2023-507249-27-00